EU clinical trial 2023-509141-12-00: Phase 2, Double-blind, Randomized, Placebo-controlled Study to Evaluate the Effects of Sotatercept versus Placebo-Controlled for the Treatment of Combined Postcapillary and Precapillary Pulmonary Hypertension (Cpc-PH) due to Heart Failure with Preserved Ejection Fraction (HFpEF)
Protocol code: A011-16
Sponsor: Acceleron Pharma Inc. (Pharmaceutical company). Phase: Therapeutic exploratory (Phase II). Countries: Belgium (ended), Germany (ended), Italy (ended), Sweden (ended), Spain (ended), France (ended), Poland (ended).
Therapeutic area(s): Diseases [C] - Cardiovascular Diseases [C14]
Gender: Female, Male. Age: 18-64 years, 65+ years. Enrolment: 174.
Status: Ended. Start date (EU): 2022-04-28. End date (EU): 2026-03-30. End date: 2026-04-09. Decision date: 2024-09-12. Results received: No. Last updated: 2025-10-10.
Decision dates by country: FR: 2024-09-12, DE: 2024-09-13, BE: 2024-09-16, SE: 2024-09-12, IT: 2024-09-23, ES: 2024-09-12, PL: 2024-09-30

Condition(s): Combined Postcapillary and Precapillary Pulmonary Hypertension (Cpc-PH) due to Heart Failure with Preserved Ejection Fraction (HFpEF)
Product: sotatercept, PL1 - Powder for injection

Primary endpoint: Change from baseline in PVR at Week 24
Endpoint(s): Time to clinical worsening at Wk 24: −Hospitalization cardiopulmonary indication −Administration IV diuretics or SC furosemide −Death −Decrease 6MWD by ≥ 15% from baseline • Change from baseline in: -hemodynamic and ECHO parameters at Wk 24 -NT-proBNP at Wk 24 - -NYHA FC at Wk 24, Cont. translations

Source: https://euclinicaltrials.eu/ctis-public/view/2023-509141-12-00